EU clinical trial 2025-521903-28-00: A Phase 3, Multicenter, Prospective, Randomized, Open-label Efficacy and Safety Study of Intravenous Brincidofovir versus Intravenous Cidofovir for Treatment of Adenovirus Infection in Pediatric and Adult Subjects After Allogeneic Hematopoietic Cell Transplantation (allo HCT)
Protocol code: BCV-PA02
Sponsor: Symbio Pharmaceuticals Ltd. (Pharmaceutical company). Phase: Therapeutic confirmatory (Phase III). Countries: Germany (authorised, recruiting), Italy (ongoing, recruiting), France (ongoing, recruiting), Spain (ongoing, recruiting).
Therapeutic area(s): Diseases [C] - Virus Diseases [C02]
Gender: Female, Male. Age: 0-17 years, 18-64 years, 65+ years. Enrolment: 72.
Start date (EU): 2026-05-06. Decision date: 2025-10-02. Results received: No. Last updated: 2026-06-26.
Decision dates by country: DE: 2025-10-02, IT: 2025-10-02, ES: 2025-10-20, FR: 2025-10-03

Condition(s): Adenovirus viremia
Product: Brincidofovir, Cidofovir

Primary endpoint: Proportion of subjects with AdV virological success
Endpoint(s): Proportion of subjects with overall success, Proportion of subjects with clinical success, Proportion of subjects with AdV virological success, Correlation of virologic success and clinical response, AdV-free survival, Time to AdV virological success, Rate of AdV recurrence, Length of hospitalization and length of ICU stay, Desirability Of Outcome Ranking (DOOR) Analysis for benefit-risk estimation, All-cause mortality, Adenovirus attributed mortality, as adjudicated by the EAC, Primary malignancy relapse-free survival, Incidence and severity of treatment-emergent adverse events (TEAEs)

Source: https://euclinicaltrials.eu/ctis-public/view/2025-521903-28-00